EU clinical trial 2022-501058-12-00: A Randomized, Double-Blind, Placebo-Controlled, Parallel Group Study to Evaluate the Efficacy of Methotrexate as Remission Maintenance Therapy after Remission-Induction Therapy with Tocilizumab and Glucocorticoids in Subjects with Giant Cell Arteritis
Protocol code: MED3-201802
Sponsor: Rheinische Friedrich Wilhelms Universität Bonn (Educational Institution). Phase: Therapeutic exploratory (Phase II). Countries: Germany (ended).
Therapeutic area(s): Diseases [C] - Immune System Diseases [C20]
Gender: Female, Male. Age: 18-64 years, 65+ years. Enrolment: 40.
Status: Ended. Start date (EU): 2022-11-23. End date (EU): 2025-10-02. Decision date: 2022-08-12. Results received: No. Last updated: 2022-08-12.

Condition(s): Giant cell arteritis
Product: Sodiumchloride, metex 50 mg/ml Injektionslösung, Fertigspritze

Primary endpoint: Time to relapse during the 12 months treatment period
Endpoint(s): 1. Cumulative prednisone doses at months 6, 12 and 18, 2. Number of flares per patient during the 12 months treatment period, Time to first, second and third relapse after randomization, Percentage of patients with a relapse at month 6 and 18 after discontinuation of tocilizumab, 3. Patient reported outcomes including SF-36, FACIT-Fatigue, Patient Global Assessment of Disease Activity (PGA), Patient assessment of pain, 4. Investigator reported outcomes including Eval-uator Global Assessment of disease activity (EGA), 5. Occurrence of symptoms and signs related to GCA, 6. Number of vasculitic vessels and change of intima-media-values during the study, 7. Prevelance of aortitis at baseline and month 12 and 18, 8. Proportion of subjects with increased ESR (>20mm/h) and CRP levels (> 10mg/L) at every visit, 9. Occurrence of adverse events and serious adverse events, incidence of glucocorticoid-related adverse events

Source: https://euclinicaltrials.eu/ctis-public/view/2022-501058-12-00